EU clinical trial 2024-513615-26-00: A Randomized, Single-dose, Crossover, Two-period, Pilot Comparative Bioavailability Study of Alendronate 70 mg effervescent vs. Fosamax 70 mg tablets in Healthy Male and Female Subjects.
Protocol code: 956/23
Sponsor: Oractive Swiss AG (Pharmaceutical company). Phase: Human Pharmacology (Phase I)- Bioequivalence Study. Countries: Czechia (ended).
Therapeutic area(s): Diseases [C] - Musculoskeletal Diseases [C05]
Gender: Female, Male. Age: 18-64 years. Enrolment: 24.
Status: Ended. Start date (EU): 2024-09-12. End date (EU): 2024-10-02. Decision date: 2024-08-02. Results received: No. Last updated: 2024-08-02.

Condition(s): not applicable (submitted trial is a comparative bioavailability study)

Source: https://euclinicaltrials.eu/ctis-public/view/2024-513615-26-00